EU clinical trial 2024-517354-98-00: Cytomegalovirus Prophylaxis with Letermovir in Heart Transplant Recipients: A Non-randomized Cohort Pilot Study
Protocol code: V1.7
Sponsor: University Medical Center Ljubljana (Hospital/Clinic/Other health care facility). Phase: Therapeutic exploratory (Phase II). Countries: Slovenia (ended).
Therapeutic area(s): Diseases [C] - Cardiovascular Diseases [C14]; Diseases [C] - Virus Diseases [C02]
Gender: Female, Male. Age: 18-64 years, 65+ years. Enrolment: 90.
Status: Ended. Start date (EU): 2024-09-17. End date (EU): 2026-05-01. Decision date: 2024-09-17. Results received: No. Last updated: 2024-09-17.

Condition(s): CMV infection in heart transplant recipients
Product: PREVYMIS 240 mg film-coated tablets

Primary endpoint: The rate of early CMV infections/disease during virostatic prophylaxis.
Endpoint(s): •The rate of leukopenia during virostatic prophylaxis, •The rate of neutropenia during virostatic prophylaxis, •The rate of late CMV infections/disease between virostatic discontinuation and 6 months thereafter., •The time-course of the restitution of cell-mediated immunity during virostatic prophylaxis, •The rate of CMV resistance to virostatic therapy.

Source: https://euclinicaltrials.eu/ctis-public/view/2024-517354-98-00